EU clinical trial 2024-515361-34-00: Head-to-head compaRison of single versus dual antiplatelet treatMent strategY after percutaneous left atrial appenDage closure: A MULticenter, randomizEd sTudy. The ARMYDA-AMULET study
Protocol code: ARMYDA-AMULET
Sponsor: Fondazione Toscana Gabriele Monasterio (Patient organisation/association). Phase: Therapeutic use (Phase IV). Countries: Italy (ongoing, recruiting).
Therapeutic area(s): Diseases [C] - Cardiovascular Diseases [C14]
Gender: Female, Male. Age: 18-64 years, 65+ years. Enrolment: 606.
Status: Ongoing, recruiting. Start date (EU): 2021-10-13. Decision date: 2024-09-16. Results received: No. Last updated: 2026-03-25.

Condition(s): Patients with atrial fibrillation undergoing percutaneous left atrial appendage closure with the Amulet device
Product: Plavix 75 mg film-coated tablets, CARDIOASPIRIN 100 mg Compresse gastroresistenti, CARDIOASPIRIN 100 mg Compresse gastroresistenti, Plavix 300 mg film-coated tablets

Primary endpoint: Primary endpoint will be the 6-month incidence in the two arms (SAPT versus DAPT) of the net composite endpoint including all-cause death, DRT (at 3- or 6-month TEE), ischemic stroke, systemic embolic events (SEE) or BARC classification bleeding ≥3 (7).
Endpoint(s): DRT at 3 and 6 months by TEE, Any-cause death, Incidence of ischemic stroke or SEE at 3 and 6 months, Incidence of any bleeding at 3 and 6 months, Incidence of BARC classification bleeding ≥3 at 3 and 6 months

Source: https://euclinicaltrials.eu/ctis-public/view/2024-515361-34-00